EU clinical trial 2025-523996-45-00: The POST-PRANDIAL HYPO-AVOID STUDY Low-Dose Glucagon and Automated Insulin Delivery for Prevention of Spontaneous Exercise-Induced Hypoglycemia in People with Type 1 Diabetes
Sponsor: Steno Diabetes Center Copenhagen (Hospital/Clinic/Other health care facility). Phase: Therapeutic use (Phase IV). Countries: Denmark (ongoing, recruiting).
Therapeutic area(s): Diseases [C] - Hormonal diseases [C19]
Gender: Female, Male. Age: 18-64 years, 65+ years. Enrolment: 18.
Status: Ongoing, recruiting. Start date (EU): 2026-04-10. Decision date: 2026-03-16. Results received: No. Last updated: 2026-03-16.

Condition(s): Type 1 Diabetes Mellitus
Product: Zegalogue 0.6 mg solution for injection in pre-filled syringe, GlucaGen HypoKit, pulver og solvens til injektionsvæske, opløsning

Primary endpoint: Change in plasma glucose (PG) from exercise initiation to the nadir during exercise and throughout the 2-hour post-exercise period.
Endpoint(s): Percent PG time in range (3.9–10.0 mmol/L) from exercise onset to +120 min (continuous), Incidence of hypoglycemia (PG <3.9 mmol/L; 0–180 min (binary), Time to hypoglycemia (PG <3.9 mmol/L; 0–180 min)., Percent time below range (PG <3.9 mmol/L; 0–180 min) (continuous), Percent time above range (PG >10.0 mmol/L; 0–180 min, (continuous), Incidence of hyperglycemia (PG >10.0 mmol/L; 0–180 min) (binary), Nadir PG concentration (0–180 min) (continuous), Peak PG concentration (0–180 min) (continuous), Incremental peak PG concentration (0–180 min) (continuous), Mean PG concentration (0–180 min) (continuous), PG area under the curve (AUC; 0–180 min) (continuous), Standard deviation of PG (0–180 min) (continuous), Coefficient of variation of PG (0–180 min) (continuous)

Source: https://euclinicaltrials.eu/ctis-public/view/2025-523996-45-00